EU clinical trial 2023-508617-16-00: A Phase 1/2, Single-arm Study to Evaluate the Safety, Pharmacokinetics, and Antitumor Activity of Avapritinib in Pediatric Patients with Solid Tumors Dependent on KIT or PDGFRA Signaling
Protocol code: BLU-285-3101
Sponsor: Blueprint Medicines Corp. (Pharmaceutical company). Phase: Phase I and Phase II (Integrated)- Other. Countries: Austria (ended), France (ended), Germany (ended), Italy (ended).
Therapeutic area(s): Diseases [C] - Neoplasms [C04]
Gender: Female, Male. Age: 0-17 years. Enrolment: 15.
Status: Ended. Start date (EU): 2022-05-22. End date (EU): 2025-06-22. End date: 2025-11-21. Decision date: 2024-05-12. Results received: Yes. Last updated: 2025-06-22.
Decision dates by country: AT: 2024-05-12, IT: 2024-05-17, FR: 2024-05-15, DE: 2024-05-15

Condition(s): Solid Tumors Dependent on KIT or PDGFRA Signaling
Product: Avapritinib, Avapritinib, Avapritinib

Primary endpoint: Part 1. Determination of the Part 2 recommended dose based on dose-limiting toxicity (DLT)., Part 1. Incidence and severity of adverse events, Part 2.Objective response rate (ORR)
Endpoint(s): Part 1 ORR, Part 2. Incidence and severity of adverse events, Part 2. Palatability assessments as measured by the 5-point Hedonic scale, Part 1 and Part 2. DOR: median and estimated rate at 6 and 12 months, Part 1 and Part 2. PFS: median and estimated rate at 6 and 12 months, Part 1 and Part 2. DCR at 24 weeks, Part 1 and Part 2. Time to response, Part 1 and Part 2. Avapritinib PK parameters including maximum plasma concentration, time to maximum plasma drug concentration (Tmax), area under the plasma concentration-time curve from 0 to 24 hours (AUC0-24), terminal elimination half-life (T1/2), and plasma concentration-time profiles (AUCs), Part 1 and Part 2. Change from baseline in levels of KIT and PDGFRA mutant allele fractions in peripheral blood at selected time points.

Source: https://euclinicaltrials.eu/ctis-public/view/2023-508617-16-00